EU clinical trial 2025-521678-32-00: ADVANCE: A Phase III Multi-Centre, Randomised, Double-Blind, Double-Dummy Clinical Trial Comparing Essentiale® Liquid vs. Capsules for MASLD/MASH, Alcoholic Liver Disease, and Chronic Viral Hepatitis B
Protocol code: LPS17913
Sponsor: Opella Healthcare Group S.A.S. (Pharmaceutical company). Phase: Therapeutic confirmatory (Phase III). Countries: Bulgaria (ongoing, recruitment ended), Germany (ongoing, recruitment ended), Poland (ongoing, recruitment ended).
Therapeutic area(s): Diseases [C] - Digestive System Diseases [C06]
Gender: Female, Male. Age: 18-64 years, 65+ years. Enrolment: 486.
Status: Ongoing, recruitment ended. Start date (EU): 2026-03-03. Decision date: 2025-09-22. Results received: No. Last updated: 2026-07-20.
Decision dates by country: DE: 2025-09-22, PL: 2025-09-23, BG: 2025-09-24

Condition(s): Chronic Viral Hepatitis B, MASLD (Metabolic Dysfunction-Associated Steatotic Liver Disease) / MASH, Metabolic Dysfunction-Associated Steatohepatitis, Alcoholic Liver Disease
Product: NC0304 Phosphatidylcholine, Essentiale Forte, 300 mg, kapsułki, Essentiale Forte, 300 mg, kapsułki, Essentiale Forte, 300 mg, kapsułki, Test Placebo: The placebo is for the test product i.e., ESSENTIALE Advance, oily liquid in stick packs - 1.8g. The placebo has different qualitative and quantitative composition as the test product, but no differentiation could be made as both placebo and test products have the same appearance, taste, smell and mouthfeel, and packaged in the same primary packaging i.e., stick packs, allowing the non-differentiation., Comparator Placebo: Standard placebo which has a different qualitative and quantitative composition from the marketed verum formulation Essentiale® 300 mg capsules but for which aspect of hard capsules is the same

Primary endpoint: Changes in overall symptoms evaluation using the GOS score
Endpoint(s): Changes in key individual symptoms using the GOS scale, Change in CLDQ global score, Incidence and severity of TEAEs

Source: https://euclinicaltrials.eu/ctis-public/view/2025-521678-32-00